EU clinical trial 2025-523367-38-00: Effect of nepafenac/dexamethasone fixed dose combination vs. its individual components (nepafenac and dexamethasone monotherapies) on postoperative inflammation after cataract surgery: a randomized, multicentre, blinded-assessor, parallel-group clinical study – NE.DE.F. STUDY
Protocol code: #0525NEDEF
Sponsor: Medivis S.r.l. (Pharmaceutical company). Phase: Therapeutic confirmatory (Phase III). Countries: Italy (ongoing, recruiting).
Therapeutic area(s): Diseases [C] - Eye Diseases [C11]
Gender: Female, Male. Age: 18-64 years, 65+ years. Enrolment: 432.
Status: Ongoing, recruiting. Start date (EU): 2026-05-11. Decision date: 2026-02-27. Results received: No. Last updated: 2026-02-27.

Condition(s): Postoperative inflammation after cataract surgery
Product: NEVANAC 1 mg/ml eye drops, suspension, Dexavision 1 mg/mL collirio, soluzione, TOBRAMICINA DOC Generici 3 mg/ml collirio, soluzione

Primary endpoint: Primary efficacy endpoint: Time to resolution of postoperative anterior chamber inflammation after cataract surgery, as defined by an anterior chamber flare score of value = 0, equal or inferior to the preoperative value.
Endpoint(s): Secondary efficacy endpoints: • Proportion of participants with resolution (flare score value = 0, equal or inferior to the preoperative value) of postoperative anterior chamber inflammation on postoperative Day 1, 3, 5, 7, 14 and 30, Secondary efficacy endpoints: • Change from baseline in the anterior chamber flare score value on postoperative Day 1, 3, 5, 7, 14 and 30, Secondary efficacy endpoints: • Change from baseline in the anterior chamber cells score on postoperative Day 1, 3, 5, 7, 14 and 30, Secondary efficacy endpoints: • Proportion of participants with absence of conjunctival hyperaemia, defined as a score equal to 0 on a 4-point Likert scale (range 0-3; 0 = none, 1 = mild, 2 = moderate, 3 = severe) on postoperative Day 1, 3, 5, 7, 14 and 30, as assessed by Slit Lamp Examination (SLE), Secondary efficacy endpoints: • Proportion of participants with a Total Ocular Symptoms Score (TOSS) equal to 0 on postoperative Day 1, 3, 5, 7 and 14, Secondary efficacy endpoints: • Proportion of participants with no ocular pain/discomfort on postoperative Day 1, 3, 5, 7 and 14, defined as a score for ocular pain/discomfort equal to 0 on a 4-point Likert scale (range 0-3; 0 = none, 1 = mild, 2 = moderate, 3 = severe), Secondary efficacy endpoints: • Change from baseline of central macular thickness (central subfield) on postoperative Day 30, as assessed by Optical Coherence Tomography (OCT), Secondary efficacy endpoints: • Proportion of participants with central macular thickness (central subfield) >300 microns and cystic changes on OCT on postoperative Day 30, Secondary efficacy endpoints: • Proportion of participants using any rescue medication during treatment, Safety and tolerability endpoints: • Incidence of all Adverse Events (AEs), Adverse Drug Reactions (ADRs), Serious Adverse Events (SAEs), Safety and tolerability endpoints: • Frequency of discontinuation of treatment due to AEs, Safety and tolerability endpoints: • Changes from baseline of IOP at each study visit, Safety and tolerability endpoints: • Proportion of participants with a significant increase (> 6 mmHg) in IOP vs. baseline at each study visit, Safety and tolerability endpoints: • Changes from baseline of Best Corrected Visual Acuity (BCVA) assessed through Snellen 20 feet chart at each study visit, Safety and tolerability endpoints: • Proportion of participants with 20/20 BCVA (Snellen 20 feet chart) on postoperative Day 14 and 30, Safety and tolerability endpoints: • Participant’s assessment of ocular complaints of burning, stinging and blurred vision on postoperative Day 1, 3, 5, 7 and 14 using a 4-point Likert scale (range 0-3; 0 = none, 1 = mild, 2 = moderate, 3 = severe), Safety and tolerability endpoints: • Participant’s global evaluation of IMP tolerability on postoperative Day 14 using a 5-point Likert scale (range 0-4; 0 = poor, 1 = slight, 2 = moderate, 3 = good, 4 = excellent), Pharmacokinetic endpoints (PK sub-study) • AUC0-t, AUC0-∞, area under the drug concentration-time curve • Cmax, maximum plasma concentration • Tmax, time of maximum plasma concentration

Source: https://euclinicaltrials.eu/ctis-public/view/2025-523367-38-00